EU clinical trial 2024-517020-18-00: A Phase 2, open-label, multicenter multi-cohort study to evaluate the efficacy and safety of anitocabtagene autoleucel in participants with newly diagnosed multiple myeloma
Protocol code: GEM-AnitoFIRST
Sponsor: Fundacion PETHEMA (Patient organisation/association). Phase: Therapeutic exploratory (Phase II). Countries: Spain (ongoing, recruitment ended).
Therapeutic area(s): Diseases [C] - Neoplasms [C04]
Gender: Female, Male. Age: 18-64 years, 65+ years. Enrolment: 30.
Status: Ongoing, recruitment ended. Start date (EU): 2025-06-30. Decision date: 2025-06-05. Results received: No. Last updated: 2025-06-25.

Condition(s): Newly diagnosed multiple myeloma according to IMWG criteria
Product: TOCILIZUMAB, CYCLOPHOSPHAMIDE, ISATUXIMAB, DARATUMUMAB, Anitocabtagene autoleucel, LENALIDOMIDE, LENALIDOMIDE, DEXAMETHASONE, BORTEZOMIB, LENALIDOMIDE, FLUDARABINE

Primary endpoint: Incidence, seriousness, and severity of all AEs, uMRD negative CR rate (minimum 10−5) at 12 months (+/- 3 months) after enrollment
Endpoint(s): uMRD negative CR rate (minimum 10−5) at 2, 6, 12, 18 and 24 months after CAR T infusion and sustained uMRD annually, CR rate (CR (sCR), as assessed by investigators according to the International Myeloma Working Group (IMWG) criteria, Overall MRD negativity (minimum 10−5), MRD-negative CR at any timepoint scheduled, Rate of conversion from undetectable to detectable MRD as well as biochemical progression rate, Time to biochemical progression (including the conversion from undetectable to detectable MRD)., undetectable MRD at 10-6, ORR per IMWG criteria, DoR, VGPR and PR rate per IMWG criteria, Time to initial response, PFS, Overall rate of “imaging plus MRD negative” (using PET/CT per IMWG), Mass spectrometry MRD, Expansion and persistence of anitocabtagene autoleucel in peripheral blood, Characterize baseline tumor burden impact on efficacy, safety and cell expansion, Assess relationship of MRD-negativity to response, progression, and survival, Explore efficacy in high-risk populations (EMD, high-risk cytogenetics, ISS stage III, etc), Characterize baseline soluble BCMA (sBCMA) and impact of Isa-VRd induction prior to anitocabtagene autoleucel and relationship to efficacy and safety, Characterize drug product attributes and relationship to efficacy and safety, Immunoprofiling by MFC in bone marrow and peripheral blood including identification and characterization of anitocabtagene autoleucel by MFC., Overall survival

Source: https://euclinicaltrials.eu/ctis-public/view/2024-517020-18-00